EU clinical trial 2023-508669-33-00: A Phase 2 Proof of Concept Study to Evaluate the Safety, Tolerability, Pharmacokinetics, Pharmacodynamics, and Preliminary Efficacy of OMS906 in Patients with C3 Glomerulopathy (C3G) and Idiopathic Immune Complex-Mediated Glomerulonephritis (ICGN)
Protocol code: OMS906-C3G-001
Sponsor: Omeros Corp. (Pharmaceutical company). Phase: Therapeutic exploratory (Phase II). Countries: Lithuania (ended), Poland (ended).
Therapeutic area(s): Diseases [C] - Immune System Diseases [C20]
Gender: Female, Male. Age: 18-64 years, 65+ years. Enrolment: 10.
Status: Ended. Start date (EU): 2024-01-29. End date (EU): 2026-04-14. End date: 2026-04-15. Decision date: 2024-08-04. Results received: No. Last updated: 2025-12-15.
Decision dates by country: PL: 2024-08-04, LT: 2024-08-13

Condition(s): C3 Glomerulopathy and Idiopathic Immune Complex-Mediated Glomerulonephritis

Primary endpoint: Safety and tolerability as assessed by adverse events (AEs), vital signs, 12-lead electrocardiograms (ECGs), and clinical laboratory tests.
Endpoint(s): Change from baseline in proteinuria measured as 24-hour UPCR at 12, 24, and 48 weeks., Change from baseline in proteinuria measured as 24-hour UPE at 12, 24, and 48 weeks., Change from baseline in proteinuria measured as 24-hour UACR at 12, 24, and 48 weeks., Change from baseline in proteinuria measured as 24-hour urine UAE at 12, 24, and 48 weeks., Change from baseline of eGFR calculated by the CKD-EPI formula at 24 and 48 weeks., Change from baseline in serum creatinine at 24 and 48 weeks., Key OMS906 PK parameters estimated using appropriate population PK methods based on sparse sampling., Serum/plasma PD parameters, including mature FD, measured as changes from baseline., Incidence of ADAs in serum.

Source: https://euclinicaltrials.eu/ctis-public/view/2023-508669-33-00